EU clinical trial 2024-513430-37-00: The FACE (Facial nerve palsy And Cortisone Evaluation) study in children: a randomised double-blind, placebo-controlled, multicenter trial.
Protocol code: FACE-01
Sponsor: Region Dalarna (Hospital/Clinic/Other health care facility). Phase: Therapeutic use (Phase IV). Countries: Sweden (ongoing, recruitment ended).
Therapeutic area(s): Diseases [C] - Nervous System Diseases [C10]
Gender: Female, Male. Age: 0-17 years. Enrolment: 500.
Status: Ongoing, recruitment ended. Start date (EU): 2019-06-01. Decision date: 2024-05-24. Results received: No. Last updated: 2025-05-14.

Condition(s): Facial Nerve Palsy (Bells Palsy)
Product: Placebo capsules corresponding to Prednisolone 5 mg for oral administration., PREDNISOLONE

Primary endpoint: Primary endpoint is the number of patients with total recovery of the facial nerve palsy measured by the House-Brackmann grading scale at 12 months follow-up. This is chosen to be a robust primary endpoint which has also been used in previous studies in pediatric and adult patients.
Endpoint(s): The total number of patients with total recovery, measured by the Sunnybrook grading scale at 12 months follow-up, in the two subgroups of patients with idiopathic or Borrelia associated facial nerve palsy., The total recovery rate with both Sunnybrook and House-Brakmann scales at 1 month compared to 12 months., Subjective symptoms and influence in Daily Life with the Facial Clinimetric Evaluation (FaCE) scale, the Facial Disability Index (FDI) and the Synkinesis Assessment Questionnaire (SAQ) at 1 and 12 months follow-up., Safety profile by adverse event reporting.

Source: https://euclinicaltrials.eu/ctis-public/view/2024-513430-37-00